EU clinical trial 2023-506518-33-00: A Phase 3, Open-Label, Randomized Study of Amivantamab and Lazertinib in Combination with Platinum-Based Chemotherapy Compared with Platinum-Based Chemotherapy in Patients with EGFR-Mutated Locally Advanced or Metastatic Non- Small Cell Lung Cancer After Osimertinib Failure
Protocol code: 61186372NSC3002
Sponsor: Janssen - Cilag International (Pharmaceutical company). Phase: Therapeutic confirmatory (Phase III). Countries: Sweden (ongoing, recruitment ended), Poland (ongoing, recruitment ended), Belgium (ongoing, recruitment ended), Germany (ended), Netherlands (ongoing, recruitment ended), Bulgaria (ongoing, recruitment ended), France (ongoing, recruitment ended), Czechia (ended), Spain (ongoing, recruitment ended), Portugal (ended), Italy (ongoing, recruitment ended), Denmark (ended).
Therapeutic area(s): Diseases [C] - Neoplasms [C04]
Gender: Female, Male. Age: 18-64 years, 65+ years. Enrolment: 259.
Start date (EU): 2021-11-10. Decision date: 2024-02-07. Results received: No. Last updated: 2026-06-05.
Decision dates by country: CZ: 2024-02-08, DK: 2024-02-07, PT: 2024-02-07, NL: 2024-02-08, BE: 2024-02-20, BG: 2024-02-23, DE: 2024-02-09, ES: 2024-02-12, IT: 2024-03-21, SE: 2024-02-08, PL: 2024-02-21, FR: 2024-02-08

Condition(s): Locally Advanced or Metastatic Non-Small Cell Lung Cancer
Product: Carboplatin 10 mg/ml Intravenous Infusion, PEMETREXED, CARBOPLATIN, JNJ-73841937, JNJ-61186372, Pemetrexed Seacross 500 mg powder for concentrate for solution for infusion, CARBO-cell® 10 mg/ml Infusionslösung, Konzentrat zur Herstellung einer Infusionslösung Carboplatin

Primary endpoint: 1. Progression-free survival (PFS) using RECIST v1.1 guidelines, as assessed by blinded independent central review (BICR).

Source: https://euclinicaltrials.eu/ctis-public/view/2023-506518-33-00